EU clinical trial 2023-503504-88-00: A Single-blind, Phase 2, Multi-center, Randomized Study to Assess Safety, Tolerability, Efficacy and Pharmacokinetics of the Relaxin Agonist R2R01 Plus Terlipressin Versus Terlipressin Alone in Patients with Hepatorenal Syndrome – Acute Kidney Injury
Protocol code: R2R01-HRS-201
Sponsor: River 2 Renal Corp. (Non-Pharmaceutical company). Phase: Therapeutic exploratory (Phase II). Countries: Italy (ended), Germany (ended).
Therapeutic area(s): Diseases [C] - Pathological Conditions, Signs and Symptoms [C23]
Gender: Female, Male. Age: 18-64 years, 65+ years. Enrolment: 18.
Status: Ended. Start date (EU): 2024-05-13. End date (EU): 2025-03-28. End date: 2025-03-29. Decision date: 2023-10-17. Results received: Yes. Last updated: 2024-11-11.
Decision dates by country: DE: 2023-10-17, IT: 2023-10-17

Condition(s): Hepatorenal Syndrome – Acute Kidney Injury
Product: TERLIPRESSIN ACETATE

Primary endpoint: Safety and tolerability will be assessed by occurrence of AEs, changes in physical examinations, vital signs, ECGs, and clinical laboratory parameters., The incidence of Responders (Established HRS reversal defined as patients with a Full or Partial HRS response (based on SCr/AKI stage) AND are alive without Renal Replacement Therapy (RRT) for at least 30 days after the first dose of study medication), evaluated separately as two different outcome groups and combined., Patients who are undergoing liver transplant during the first 30 days after treatment start will have their SCr and AKI stage evaluated before the transplant and will be considered responders if meeting the criteria for SCr/AKI stage for HRS response (Full or Partial) before the liver transplant and are alive and without RRT at day 30 after treatment start., In case of recurrence and retreatment during the first 30 days, the second treatment period will be evaluated for response.
Endpoint(s): Number of patients who died (mortality rate) at day 30, 60, and 90., Number of patients with renal and/or liver transplant at day 30, 60, and 90., Number of patients with RRT at day 30, 60, and 90., Number of patients with durable Established HRS reversal (number of patients with a Full or Partial HRS Response and without RRT by day 45, 60, and 90), the two response categories evaluated in a separate and combined manner., Number of patients with HRS recurrence., Number of patients with an HRS response based on SCr/AKI stage as Full, Partial, and Combined., Number of patients with worsening of ACLF 1 or 2 to stage 3, or improvement from stage 2 to stage 1., Mean change from baseline in MELD score at day 30, 60, and 90., The number of responding patients with an Established HRS reversal where the clinical definition is patient alive without RRT 10 days after the achievement of HRS response (i.e., as per the CONFIRM study)., Mean change from baseline in serum and urine biomarkers (including Cystatin C, Endothelin-1, vWF, NGAL, KIM 1)., Population PK analysis will be performed to derive primary PK parameters (e.g., absorption rate (ka), apparent Clearance (CI/F) and apparent volume of distribution (V/F)) and secondary PK parameters (maximum concentrations (Cmax), time of Cmax (tmax), minimum plasma concentrations (Cmin), area under the concetration time curve over the dosing interval (AUC 024b), elimination halft life(t1/2), and accumulation ratio (Racc).

Source: https://euclinicaltrials.eu/ctis-public/view/2023-503504-88-00